EU clinical trial 2024-514701-57-01: A randomized phase II study of Pembrolizumab (MK-3475) as maintainance therapy in patients with unresectable stage III non-small cell lung cancer treated with definitive chemo-radiotherapy (MP-LALC- Maintainance Pembrolizumab in Locally Advanced Lung Cancer).
Protocol code: MP-LALC
Sponsor: Universita' Degli Studi Di Torino (Educational Institution). Phase: Therapeutic exploratory (Phase II). Countries: Italy (authorised, recruitment pending).
Therapeutic area(s): Diseases [C] - Neoplasms [C04]; Diseases [C] - Respiratory Tract Diseases [C08]
Gender: Female, Male. Age: 18-64 years, 65+ years. Enrolment: 126.
Status: Authorised, recruitment pending. Decision date: 2024-12-16. Results received: No. Last updated: 2025-07-01.

Condition(s): non Small Cell Lung Cancer
Product: KEYTRUDA 25 mg/mL concentrate for solution for infusion

Primary endpoint: Median overall survival (OS) time
Endpoint(s): Overall survival (OS) defined as the time from randomization to death or last follow-up, Progression Free Survival (PFS) intended as the time from randomization to disease progression or death, Overall Response Rate (ORR)

Source: https://euclinicaltrials.eu/ctis-public/view/2024-514701-57-01